EU clinical trial 2024-511010-21-00: (PREVENT)A Randomized, Double-blind, Placebo-controlled Trial on the Prevention of Chronic Postoperative Pain after Inguinal Hernia and Knee Surgery by Postoperative Treatment with Tapentadol
Sponsor: Leids Universitair Medisch Centrum (LUMC) (Hospital/Clinic/Other health care facility). Phase: Therapeutic use (Phase IV). Countries: Netherlands (ongoing, recruiting).
Therapeutic area(s): Diseases [C] - Nervous System Diseases [C10]
Gender: Female, Male. Age: 18-64 years, 65+ years. Enrolment: 540.
Status: Ongoing, recruiting. Start date (EU): 2024-07-22. Decision date: 2024-07-22. Results received: No. Last updated: 2024-07-22.

Condition(s): chronic postoperative pain
Product: PALEXIA Retard 50 mg tabletten met verlengde afgifte

Primary endpoint: The effect of Tapentadol compared to placebo on the development of chronic pain in the first year after surgery in patients planned for elective inguinal hernia surgery and knee replacement surgery.

Source: https://euclinicaltrials.eu/ctis-public/view/2024-511010-21-00